EU clinical trial 2023-509260-25-00: A Phase 3, Open-label, Randomised Study of Datopotamab Deruxtecan (Dato-DXd) Versus Investigator’s Choice of Chemotherapy in Patients who are not Candidates for PD-1/PD-L1 Inhibitor Therapy in First-line Locally Recurrent Inoperable or Metastatic Triple-negative Breast Cancer (TROPION-Breast02)
Protocol code: D926PC00001
Sponsor: AstraZeneca AB (Pharmaceutical company). Phase: Therapeutic confirmatory (Phase III). Countries: Spain (ongoing, recruitment ended), Poland (ended), Hungary (ongoing, recruitment ended), France (ongoing, recruitment ended), Italy (ongoing, recruitment ended), Belgium (ended), Germany (ended).
Therapeutic area(s): Diseases [C] - Neoplasms [C04]
Gender: Female, Male. Age: 18-64 years, 65+ years. Enrolment: 177.
Start date (EU): 2022-07-12. Decision date: 2024-05-09. Results received: No. Last updated: 2026-05-06.
Decision dates by country: BE: 2024-06-11, DE: 2024-05-14, HU: 2024-05-09, ES: 2024-05-23, PL: 2024-05-16, IT: 2024-05-13, FR: 2024-05-14

Condition(s): Locally Recurrent Inoperable or Metastatic Triple-negative Breast Cancer
Product: CAPECITABINE, CAPECITABINE, CARBOPLATIN, Datopotamab deruxtecan, ERIBULIN MESYLATE, PACLITAXEL ALBUMIN-BOUND, PACLITAXEL

Primary endpoint: PFS is defined as time from randomisation until progression per RECIST 1.1 as assessed by BICR, or death due to any cause., OS is defined as the time from randomisation until the date of death due to any cause. The analysis will include all randomised participants, by treatment group as randomised. The measure of interest is the HR of OS
Endpoint(s): Objective Response Rate: Objective response rate is defined as the proportion of participants who have a confirmed CR or PR, as determined by the BICR/Investigator assessment, per RECIST 1.1., Duration of Response: Duration of response is defined as the time from the date of first documented confirmed response until date of documented progression per RECIST 1.1, as assessed by BICR/Investigator assessment or death due to any cause., Progression-Free Survival by Investigator assessment: PFS by Investigator assessment will be defined as the time from the date of randomization until the date of PD per RECIST 1.1 (by Investigator assessment) or death (by any cause in the absence of progression), (ie, date of event or censoring – date of randomization + 1)., Disease Control Rate (DCR): Defined as best overall response of CR or PR or SD (without subsequent cancer therapy) per RECIST 1.1, as assessed by BICR/per investigator assessment and maintained for ≥ 11 weeks from randomization. DCR at 12 weeks (DCR-12) is defined as the percentage of subjects who have disease control., Time to First Subsequent Therapy (TFST): Time to first subsequent therapy is defined as the time from randomization until the start date of the first subsequent anti-cancer therapy after discontinuation of randomized treatment, or death due to any cause., Time to Second Subsequent Therapy (TSST): Time to second subsequent therapy is defined as the time from randomization to until the start date of the second subsequent anti-cancer therapy after discontinuation of first subsequent treatment, or death due to any cause., Time from randomization to second progression or death (PFS2): Time to second progression of death will be defined as the time from the randomization to the earliest of the progression event (following the initial progression), subsequent to first subsequent therapy, or death. The date of second progression will be recorded by the Investigator in the eCRF and defined according to local standard clinical practice based on radiological or clinical progression., Clinical Outcome Assessments: TTD in a) pain (EORTC IL146), b) physical functioning (EORTC IL146), c) GHS/QoL (EORTC IL146), d) breast symptoms (EORTC IL116), e) arm symptoms (EORTC IL116)., Pharmacokinetics, Immunogenicity, Safety & tolerability

Source: https://euclinicaltrials.eu/ctis-public/view/2023-509260-25-00